EU clinical trial 2023-508124-36-00: To Evaluate the Safety, Tolerability, and Pharmacokinetics of Inavolisib Single Agent in Participants With Solid Tumors and in Combination With Endocrine and Targeted Therapies in Participants With Breast Cancer
Protocol code: GO39374
Sponsor: Genentech Inc. (Pharmaceutical company). Phase: Human Pharmacology (Phase I)- First administration to humans. Countries: Spain (ended).
Therapeutic area(s): Diseases [C] - Neoplasms [C04]
Gender: Female, Male. Age: 18-64 years, 65+ years. Enrolment: 41.
Status: Ended. Start date (EU): 2024-05-10. End date (EU): 2026-02-16. Decision date: 2024-05-10. Results received: No. Last updated: 2026-02-16.

Condition(s): Advanced or metastatic breast cancer and other advanced or metastatic solid tumors

Source: https://euclinicaltrials.eu/ctis-public/view/2023-508124-36-00